EU clinical trial 2024-520137-74-00: A Phase 2, Randomized, Controlled, Multicenter Study of Vosoritide in Children With Idiopathic Short Stature
Protocol code: 111-210
Sponsor: Biomarin Pharmaceutical Inc. (Pharmaceutical company). Phase: Therapeutic exploratory (Phase II). Countries: Germany (ongoing, recruiting), France (ongoing, recruiting), Italy (ongoing, recruiting).
Therapeutic area(s): Diseases [C] - Hormonal diseases [C19]
Gender: Female, Male. Age: 0-17 years, 18-64 years. Enrolment: 31.
Status: Ongoing, recruiting. Start date (EU): 2025-10-10. Decision date: 2025-06-24. Results received: No. Last updated: 2026-08-06.
Decision dates by country: DE: 2025-07-08, IT: 2025-07-16, FR: 2025-06-24

Condition(s): Idiopathic Short Stature (ISS)
Product: Voxzogo 1.2 mg powder and solvent for solution for injection, Lyophilized powder for reconstitution, Voxzogo 0.56 mg powder and solvent for solution for injection, modified recombinant human C-type natriuretic peptide (rhCNP)

Primary endpoint: Dose-Finding Phase: Change from baseline in AGV at 6 months Long-Term Phase: Change from baseline in height and height Z-score at 4 years
Endpoint(s): 1. Incidence of treatment-emergent adverse events over the course of the study, 2. Change from baseline in height Z-score at 6 months, 3. Change from baseline in height at each visit and at FAH, 4. Change from baseline in height Z-score at each visit and at FAH, 5. PK parameters (eg, Tmax, Cmax, AUC0-t, AUC0-inf, t1/2, CL/F, Vz/F), 6. Change from baseline at prespecified timepoints in: • urine cGMP • serum CXM, 7. Change from baseline in bone age/chronological age at prespecified timepoints, 8. Change from baseline at each visit in the following, as measured by DXA: • whole body (less head) BMD Z-score • lumbar spine BMD Z-score • whole body (less head) BMC • lumbar spine BMC

Source: https://euclinicaltrials.eu/ctis-public/view/2024-520137-74-00